EU clinical trial 2024-518696-65-00: A Phase 1 study to evaluate the metabolism of [14C]PF-07104091 in healthy adult male participants
Protocol code: C4161006
Sponsor: Pfizer Inc. (Pharmaceutical company). Phase: Human Pharmacology (Phase I)- Other. Countries: Netherlands (ended).
Therapeutic area(s): Diseases [C] - Neoplasms [C04]
Gender: Male. Age: 18-64 years. Enrolment: 9.
Status: Ended. Start date (EU): 2025-08-12. End date (EU): 2025-11-07. End date: 2025-11-08. Decision date: 2025-07-22. Results received: No. Last updated: 2025-10-06.

Condition(s): (HR) -positive human epidermal growth factor receptor 2 (HER2) -negative breast cancer (BC), non-small cell lung cancer (NSCLC), ovarian cancer, and triple negative breast cancer (TNBC)

Source: https://euclinicaltrials.eu/ctis-public/view/2024-518696-65-00